EU clinical trial 2024-514567-26-00: NAVIG-1 : New adjuvant vaccine in glioblastoma, a Phase 1/2a study
Protocol code: APHP240512
Sponsor: Assistance Publique Hopitaux De Paris (Hospital/Clinic/Other health care facility). Phase: Phase I and Phase II (Integrated)- First administration to humans. Countries: France (ongoing, recruiting).
Therapeutic area(s): Diseases [C] - Nervous System Diseases [C10]
Gender: Female, Male. Age: 18-64 years, 65+ years. Enrolment: 90.
Status: Ongoing, recruiting. Start date (EU): 2024-11-08. Decision date: 2024-09-05. Results received: No. Last updated: 2026-05-11.

Condition(s): glioblastoma
Product: Peptide A49 associated to melanin, Peptide A52 associated to melanin, Litenimod solution

Primary endpoint: Phase 1 : Safety. Safety AEs will be evaluated and graded according to CTCAE v5.0 a) clinically at D0, W2, W4, W6, M2, M3, M4, M5, M7, M9, M11 and M12 ; b) with blood samples at D0, W2, W4, W6, M2, M3, M5, M7, M9, M11 and M12 ; c) with cerebral MRI at baseline, M2, M3 and every 2 months thereafter. Phase 2a : immune efficacy: anti-TERT specific T cell responses in peripheral blood using IFN-gamma ELISPOT at 2 months post first immunizations.
Endpoint(s): Evolution over time of anti-PTPRZ1 and anti-TERT immune T cell responses triggered by the vaccination protocol in peripheral blood using IFN-gamma ELISPOT before and during treatment (W2 for phase 1 only, W4, M2, M3, M5, M7, M9 and M12), Short and long-time safety, assessed clinically at D0, W2, W4, W6, M2, M3, M4, M5, M7, M9, M11 and M12 and with blood samples at D0, W2, W4, W6, M2, M3, M5, M7, M9, M11 and M12, Progression free survival with cerebral MRI at baseline, M2, M3 and every 2 months thereafter, Overall survival, Quality of life by EORTC QLQ30 and BN20 questionnaires at baseline and at 5 months, Cardiac safety in a cohort of 8 patients enrolled in the Phase 2a study assessed at D0 (pre injection and D0 + 3 hours), day 7, W2 and M2 and with blood samples at D0, W2 and M2, Circulating anti-melanin antibodies at baseline and M2 in a cohort of 8 patients enrolled in the Phase 2a

Source: https://euclinicaltrials.eu/ctis-public/view/2024-514567-26-00